EU clinical trial 2025-521791-63-00: Phase 2 Study to Assess the Efficacy and Safety of SPY002-072 in Adults with Moderately to Severely Active Rheumatologic Disease
Protocol code: SPY002-072-201
Sponsor: Spyre Therapeutics Inc. (Pharmaceutical company). Phase: Therapeutic exploratory (Phase II). Countries: Czechia (ongoing, recruitment ended), Poland (ongoing, recruitment ended), Spain (ongoing, recruitment ended), Bulgaria (ongoing, recruitment ended).
Therapeutic area(s): Diseases [C] - Immune System Diseases [C20]
Gender: Female, Male. Age: 18-64 years, 65+ years. Enrolment: 210.
Status: Ongoing, recruitment ended. Start date (EU): 2025-12-18. Decision date: 2025-11-25. Results received: No. Last updated: 2026-07-20.
Decision dates by country: BG: 2025-12-08, ES: 2025-11-25, PL: 2025-12-08, CZ: 2025-12-02

Condition(s): Moderately to Severely Active Rheumatologic Disease
Product: SPY072, SPYPBO-101 Placebo to SPY072

Primary endpoint: RA Substudy: Change from baseline in DAS28-CRP at Week 12. axSpA Substudy: Change in ASDAS from baseline to Week 16. PsA Substudy: Proportion of participants who achieve an ACR20 response at Week 16.
Endpoint(s): RA Substudy: Proportion of participants who achieve an ACR20 response at Week 12. axSpA Substudy: Proportion of participants who achieve an ASAS40 response at Week 16. PsA Substudy: Change in DAPSA from baseline to Week 16., RA Substudy: PK concentration through Week 12. axSpA Substudy: PK concentration through Week 16. PsA Substudy: PK concentration through Week 16., RA Substudy: The proportion of participants with ADA through Week 12. axSpA Substudy: The proportion of participants with ADA through Week 16. PsA Substudy: The proportion of participants with ADA through Week 16., RA Substudy: Incidence of TEAEs, SAEs, AESIs, and AEs leading to IP discontinuation through Week 12 and through the end of study. axSpA Substudy: Incidence of TEAEs, SAEs, AESIs, and AEs leading to IP discontinuation through Week 16 and through the end of study. PsA Substudy: Incidence of TEAEs, SAEs, AESIs, and AEs leading to IP discontinuation at Week 16 and through the end of study.

Source: https://euclinicaltrials.eu/ctis-public/view/2025-521791-63-00